EU clinical trial 2024-519758-35-01: English Title: Tapering of biologics in CRSwNP Subtitle: Tapering of Mepolizumab or Dupilumab after 12 months of complete or partial disease control in patients with severe chronic rhinosinusitis with nasal polyposis – a national Danish RCT.
Sponsor: Rigshospitalet (Hospital/Clinic/Other health care facility). Phase: Therapeutic use (Phase IV). Countries: Denmark (ongoing, recruiting).
Therapeutic area(s): Diseases [C] - Otorhinolaryngologic Diseases [C09]
Gender: Female, Male. Age: 18-64 years, 65+ years. Enrolment: 135.
Status: Ongoing, recruiting. Start date (EU): 2025-05-27. Decision date: 2025-04-28. Results received: No. Last updated: 2025-11-12.

Condition(s): chronic rhinosinusitis with nasal polyps (CRSwNP)
Product: MEPOLIZUMAB, DUPILUMAB

Primary endpoint: In "controlled" patients presence of 0 & in "partly controlled" patients max. 2 of the following 7 items: 1) Nasal blockage: present on most days of the week, 2) Rhinorrhoea/postnasal drip: mucopurulent on most days of the week, 3) Facial pain/pressure: present on most days of the week, 4) Sense of smell: impaired, 5) Sleep disturbance or fatigue: present, 6) Nasal endoscopy: diseased mucosa, 7) Rescue treatment (systemic corticosteroids, ESS, antibiotics): need of 1 course of rescue treatment
Endpoint(s): 1) changes in SNOT-22, ACQ and smell test scores from baseline to 52 weeks; 2) changes in disease control assessments from baseline to 52 weeks by given drug; and 3) baseline and demographic data such as: age, sex, comorbidities, BMI, level of education, duration of biologic treatment.

Source: https://euclinicaltrials.eu/ctis-public/view/2024-519758-35-01